EU clinical trial 2024-517984-21-00: First-in-human (FIH) Study of DS-1471a in Subjects with Advanced Solid Tumors
Protocol code: DS1471-079
Sponsor: Daiichi Sankyo Co. Ltd. (Pharmaceutical company). Phase: Human Pharmacology (Phase I)- First administration to humans. Countries: Belgium (ended), Spain (ended), France (ended).
Therapeutic area(s): Diseases [C] - Neoplasms [C04]
Gender: Female, Male. Age: 18-64 years, 65+ years. Enrolment: 19.
Status: Ended. End date (EU): 2025-07-29. End date: 2025-07-29. Decision date: 2025-04-25. Results received: No. Last updated: 2025-07-01.
Decision dates by country: BE: 2025-04-28, FR: 2025-04-30, ES: 2025-04-25

Condition(s): Advanced Solid Tumors

Source: https://euclinicaltrials.eu/ctis-public/view/2024-517984-21-00